EU clinical trial 2023-504263-16-00: An Open-Label, Multicenter Extension Study in Patients Previously Enrolled in a Genentech and/or F. Hoffmann-La Roche Ltd Sponsored Study
Protocol code: BX44273
Sponsor: F. Hoffmann-La Roche AG (Pharmaceutical company). Phase: Therapeutic confirmatory (Phase III). Countries: Belgium (ongoing, recruiting), France (ongoing, recruiting), Poland (ongoing, recruiting), Greece (ongoing, recruiting).
Therapeutic area(s): Diseases [C] - Neoplasms [C04]
Gender: Female, Male. Age: 18-64 years, 65+ years. Enrolment: 23.
Status: Ongoing, recruiting. Start date (EU): 2023-05-25. Decision date: 2024-01-08. Results received: No. Last updated: 2026-08-07.
Decision dates by country: PL: 2024-02-29, BE: 2024-01-08, FR: 2024-01-08, GR: 2025-04-29

Condition(s): This is an extension study designed to provide continued treatment for eligible patients with cancer who were previously enrolled and treated in a Genentech/Roche study (the parent study), and do not have access to the treatment locally
Product: Rozlytrek, Avastin 25 mg/ml concentrate for solution for infusion., INAVOLISIB, Ipatasertib, RO7538483, Tecentriq 1 200 mg concentrate for solution for infusion, Rozlytrek 200 mg hard capsules, INAVOLISIB, RO 743-5846/F04, LENVIMA 4 mg hard capsules, RO 743-5846/F06, Rozlytrek, Rozlytrek 100 mg hard capsules, ABIRATERONE, Rozlytrek, Ipatasertib, Tiragolumab

Primary endpoint: 1. Number of Participants with Continued Access to Roche IMP(s)-Based Therapy and/or Comparator Agent(s)
Endpoint(s): 1. The incidence, nature, and severity of selected adverse events as described in IMP-specific appendices

Source: https://euclinicaltrials.eu/ctis-public/view/2023-504263-16-00